EU clinical trial 2024-514107-34-00: FFCD 2006 – NEORAF : A MULTI-CENTRE, OPEN-LABEL, PILOT TRIAL EVALUATING THE COMBINATION ENCORAFENIB AND CETUXIMAB IN A NEOADJUVANT SETTING IN PATIENTS WITH BRAF V600E-MUTATED LOCALISED COLON OR UPPER RECTUM CANCER
Protocol code: FFCD 2006 NEORAF
Sponsor: Fondation Franc.Cancerologie Digestive (Hospital/Clinic/Other health care facility). Phase: Therapeutic exploratory (Phase II). Countries: France (ongoing, recruiting).
Therapeutic area(s): Diseases [C] - Neoplasms [C04]; Diseases [C] - Digestive System Diseases [C06]
Gender: Female, Male. Age: 18-64 years, 65+ years. Enrolment: 30.
Status: Ongoing, recruiting. Start date (EU): 2024-07-18. Decision date: 2024-07-18. Results received: No. Last updated: 2026-01-29.

Condition(s): BRAF V600E-MUTATED LOCALISED COLON OR UPPER RECTUM CANCER
Product: Braftovi 75 mg hard capsules, Erbitux 5 mg/mL solution for infusion

Primary endpoint: To assess, in patients with localized BRAFV600E mutated CRC treated with neoadjuvant encorafenib and cetuximab: Safety and Feasibility
Endpoint(s): Non serious Toxicities (related and not related)., Overall survival, Disease free survival, The response rate in CT-scan according to RECIST 1.1 criteria, Post-operative morbidity and mortality, Quality of life (EQ5D), Tumour regression rate (TRG0 to TRG2), Recurrence free survival, The dose intensity of cetuximab and encorafenib

Source: https://euclinicaltrials.eu/ctis-public/view/2024-514107-34-00